EU clinical trial 2023-505851-33-00: An Open-label, Single-arm Study to Assess the Safety, Pharmacokinetics, and Efficacy of Adjunctive Cannabidiol Oral Solution (GWP42003‑P) in Participants with Tuberous Sclerosis Complex (1 Month to < 2 Years of Age), Dravet Syndrome (1 Year to < 2 Years of Age), or Lennox-Gastaut Syndrome (1 Year to < 2 Years of Age) who Experience Inadequately‑controlled Seizures
Protocol code: GWEP17005
Sponsor: Gw Research Limited, Jazz Pharmaceuticals Research UK Limited (Pharmaceutical company). Phase: Therapeutic confirmatory (Phase III). Countries: Italy (ended), Spain (ended).
Therapeutic area(s): Diseases [C] - Nervous System Diseases [C10]
Gender: Female, Male. Age: 0-17 years. Enrolment: 10.
Status: Ended. Start date (EU): 2024-07-29. End date (EU): 2024-11-25. End date: 2025-01-28. Decision date: 2023-11-29. Results received: Yes. Last updated: 2024-07-17.
Decision dates by country: IT: 2023-11-29, ES: 2023-11-30

Condition(s): Dravet Syndrome, Tuberous sclerosis complex, Lennox-Gastaut Syndrome
Product: Epidyolex 100 mg/ml oral solution

Primary endpoint: Adverse events (frequency,type and severity). Vital signs. Physical examination. 12-lead electrocardiogram(ECG). Clinically significant changes in laboratory parameters. Emergence of new seizure types as recorded by AE reporting. Comphrensive neuredevelopmental assessment., 3-hour and 6-hour postdose plasma concentrations of GWP42003-P and its major metabolites following multiple doses of GWP42003-P., Percentage change from baseline in indication-specific countable seizures (average per 28 days) as recorded by caregivers on seizure diaries at Week 12, every 4 weeks thereafter, and during the 4-week period prior to end of treatment (EOT)., Comprhensive neuredevelopmental assessment
Endpoint(s): Total countable seizures(average per28days)as recorded by caregivers on seizure diaries at W12,every 4W thereafter,and during the 4W period prior to EOT will be used to determine the following endpoints: N. and percentage of participants considered treatment responders,defined as those with a ≥50% reduction from baseline in tot countable seizures.Categorical percentage change from baseline to EOT in tot countable seizures.Seizure freedom,defined as 100% reduction from baseline, Percentage of participants still taking GWP42003-P at Week 12 and every 4 weeks thereafter, Exploratory: Percent change in seizure frequency from baseline to EOT as captured by prolonged multichannel (minimum of 8 channels) VEEG of up to 24 hours of recording. Change in VEEG seizure burden (e.g., seizure type (s) and frequency recorded during VEEGs) from baseline to EOT. Where possible, correlation of multichannel VEEG-recorded seizures with seizure frequency recorded by investigators and caregivers., Exploratory: Percent change from baseline in scores of ITQOL-SF47 caregiver questionnaire at EOT, Exploratory: Correlation between time of food intake and time of dosing obtained from diaries completed during the 24 hours before pharmacokinetic (PK) collection visits

Source: https://euclinicaltrials.eu/ctis-public/view/2023-505851-33-00